EU clinical trial 2024-513394-42-01: Long-term outcomes in immunologically low-risk kidney transplant recipients using tacrolimus
Sponsor: Erasmus Universitair Medisch Centrum Rotterdam (Erasmus MC) (Hospital/Clinic/Other health care facility). Phase: Phase III and phase IV (Integrated). Countries: Netherlands (authorised, recruitment pending).
Therapeutic area(s): Phenomena and Processes [G] - Immune system processes [G12]
Gender: Female, Male. Age: 18-64 years, 65+ years. Enrolment: 66.
Status: Authorised, recruitment pending. Decision date: 2025-01-27. Results received: No. Last updated: 2025-01-27.

Condition(s): Vaccination response
Product: Pneumovax 23, oplossing voor injectie in een voorgevulde spuit Pneumokokkenpolysacharidevaccin

Primary endpoint: a. Renal function and proteinuria. (creatinin and CKD-EPI; urine spot protein/ creatinine) b. Patient survival. c. Rejection episodes. d. Infectious complications: opportunistic infections, use of antibiotics. e. Malignancy o Skin (diagnosed via routine dermatology check-up) o Non-skin.
Endpoint(s): Determination of donor-specific antibodies using Luminex single-antigen beads 4, 6 and 10 years after transplantation., Quantification of pneumococcal vaccination response 3 and 5 years after pneumococcal vaccination (year 4 and 6 after kidney transplantation) with the 23-serotype polyvalent pneumococcal vaccine; and 3 weeks and one year after booster vaccination 5 years after the initial vaccination.

Source: https://euclinicaltrials.eu/ctis-public/view/2024-513394-42-01